EU clinical trial 2023-504320-25-00: A Phase 2, Multicenter, Randomized, Double-blind, Placebo-Controlled, Study to Evaluate the Efficacy and Safety of Afimetoran in Participants with Active Systemic Lupus Erythematosus.
Protocol code: IM026-024
Sponsor: Beeline Medicines Corp. (Pharmaceutical company). Phase: Therapeutic exploratory (Phase II). Countries: Romania (ongoing, recruitment ended), Ireland (ended), Spain (ongoing, recruitment ended), Germany (ongoing, recruitment ended), France (ended), Poland (ended).
Therapeutic area(s): Diseases [C] - Immune System Diseases [C20]
Gender: Female, Male. Age: 18-64 years, 65+ years. Enrolment: 86.
Start date (EU): 2021-11-25. Decision date: 2023-09-22. Results received: No. Last updated: 2026-08-06.
Decision dates by country: FR: 2023-09-28, DE: 2023-09-26, IE: 2023-09-22, ES: 2023-09-22, RO: 2023-09-29, PL: 2023-11-15

Condition(s): Active Systemic Lupus Erythematosus
Product: Afimetoran, Afimetoran, Afimetoran placebo

Primary endpoint: Proportion of participants who achieve an SLE Responder Index 4 (SRI[4]) response at Week 48
Endpoint(s): Proportion of participants that achieve a British Isles Lupus Assessment Group (BILAG)-based Combine Lupus Assessment (BICLA) at Week 24 and Week 48, Proportion of participants who achieve an SRI(4) response at Week 24, Proportion of participants who achieve a Lupus Low Disease Activity State (LLDAS) response at Week 24 and Week 48, Proportion of participants with a Cutaneous Lupus Erythematosus Disease Area and Severity Index; Activity (CLASI-A) score ≥ 10 at baseline who achieve a decrease of ≥ 50% from baseline CLASI-A score (CLASI-50) response at Week 24 and Week 48, Proportion of participants with 6 or more swollen joints and 6 or more tender joints at baseline who achieve a ≥ 50% reduction from baseline in both swollen and tender joints at Week 24 and Week 48, Mean change from baseline in swollen joint count using the 28-joint count at Week 24 and Week 48 in participants with ≥ 2 swollen joints at baseline, Mean change from baseline in tender joint count at Week 24 and Week 48 using the 28- joint count in participants with ≥ 2 tender joints at baseline, Change from baseline in PGA score of disease activity at Week 24 and Week 48, Proportion of participants who achieve CS reduction or maintenance to ≤ 7.5 mg per day at Week 48, Change in patient reported disease activity from baseline to Week 24 and Week 48 according to the (36-item Short Form Health Questionnaire) SF-36, Number of participants that experience Serious Adverse Events (SAEs), Proportion of participants that experience SAEs, Number of participants that experience Adverse Events (AEs), Proportion of participants that experience AEs, Number of participants that experience abnormalities or clinically important changes in clinical laboratory values (Hematology tests; Chemistry tests, Coagulation tests, Urinalysis tests, Serology tests), Proportion of participants that experience abnormalities or clinically important changes in clinical laboratory values (Hematology tests; Chemistry tests, Coagulation tests, Urinalysis tests, Serology tests), Number of participants that experience abnormalities or clinically important changes in physical examination, Proportion of participants that experience abnormalities or clinically important changes in physical examination, Number of participants that experience abnormalities or clinically important changes in vital signs (body temperature, Respiratory rate, Blood pressure, Heart rate), Proportion of participants that experience abnormalities or clinically important changes in vital signs (body temperature, Respiratory rate, Blood pressure, Heart rate), Number of participants that experience abnormalities or clinically important changes in Electrocardiogram (ECG) parameters (PR Interval, QRS, QT interval, QtCF), Proportion of participants that experience abnormalities or clinically important changes in ECG parameters (PR Interval, QRS, QT interval, QtCF)

Source: https://euclinicaltrials.eu/ctis-public/view/2023-504320-25-00